EU clinical trial 2024-519709-37-00: A Single Arm Study to Evaluate the Efficacy and Safety of Pozelimab and Cemdisiran Combination Therapy in Patients with Paroxysmal Nocturnal Hemoglobinuria with Inadequate Control of Intravascular Hemolysis on Currently Available C5 Inhibitor Therapy
Protocol code: R3918-PNH-2483
Sponsor: Regeneron Pharmaceuticals Inc. (Pharmaceutical company). Phase: Therapeutic confirmatory (Phase III). Countries: Poland (authorised, recruitment pending), Italy (authorised, recruitment pending), Spain (authorised, recruitment pending).
Therapeutic area(s): Diseases [C] - Hemic and Lymphatic Diseases [C15]
Gender: Female, Male. Age: 18-64 years, 65+ years. Enrolment: 8.
Status: Authorised, recruitment pending. Decision date: 2025-10-21. Results received: No. Last updated: 2026-03-25.
Decision dates by country: PL: 2025-10-26, IT: 2025-10-22, ES: 2025-10-21

Condition(s): Paroxysmal nocturnal hemoglobinuria (PNH)
Product: Pozelimab, Cemdisiran

Primary endpoint: Percent change in Lactate Dehydrogenase (LDH) during treatment period (TP) from baseline to week 28.
Endpoint(s): Normalization of LDH through week 52., Adequate control of hemolysis (LDH ≤1.5 × ULN) through week 52., Transfusion avoidance through week 52., Hemoglobin stabilization through week 52., Change in hemoglobin through week 52., Change in fatigue through week 52, as measured by the Functional Assessment of Chronic Illness Therapy (FACIT)-Fatigue Scale., Occurrence of all Adverse Events (AEs) through week 52., Severity of all AEs through week 52., Occurrence of all Treatment-Emergent Adverse Events (TEAEs) through week 52., Severity of all TEAEs through week 52., Change from baseline in Total Complement Hemolytic Activity Assay (CH50) through week 52., Concentrations of total pozelimab through week 52., Concentrations of cemdisiran through week 52., Concentrations of total C5 through week 52., Incidence of Anti-Drug Antibody (ADA) to pozelimab through week 52., Magnitude of ADA to pozelimab though week 52., Incidence of ADA to cemdisiran through week 52., Magnitude of ADA to cemdisiran through week 52., Percent change in LDH during extension treatment period (EP) from baseline to week 24 and week 52.

Source: https://euclinicaltrials.eu/ctis-public/view/2024-519709-37-00